EU clinical trial 2023-508478-27-00: EORTC-1537-LYMG: Very early FDG-PET-response adapted targeted therapy for advanced Hodgkin lymphoma: a single-arm phase II study
Protocol code: 1537-LYMG
Sponsor: European Organisation For Research And Treatment Of Cancer (Patient organisation/association). Phase: Therapeutic exploratory (Phase II). Countries: Denmark (ongoing, recruitment ended), Portugal (ongoing, recruitment ended), Spain (ongoing, recruitment ended), Poland (ongoing, recruitment ended), Slovakia (ongoing, recruitment ended), Belgium (ongoing, recruitment ended), Netherlands (ongoing, recruitment ended).
Therapeutic area(s): Diseases [C] - Neoplasms [C04]
Gender: Female, Male. Age: 18-64 years. Enrolment: 7.
Status: Ongoing, recruitment ended. Start date (EU): 2019-07-30. Decision date: 2024-10-16. Results received: No. Last updated: 2026-01-23.
Decision dates by country: BE: 2024-10-17, DK: 2024-10-23, PT: 2024-10-18, ES: 2024-10-22, NL: 2024-10-16, PL: 2024-11-08, SK: 2024-10-18

Condition(s): Advanced stage Hodgkin Lymphoma
Product: ADCETRIS 50 mg powder for concentrate for solution for infusion, DACARBAZINE, DOXORUBICIN, DEXAMETHASONE, VINBLASTINE, CYCLOPHOSPHAMIDE, ETOPOSIDE

Primary endpoint: Modified progression-free survival rate at 2 years after start of treatment (2yr-mPFS for each patient). The following are considered events for the primary endpoint: progression/relapse; start of new treatment for cHL when not in CR after completing protocol treatment; death from any cause.
Endpoint(s): FDG-PET result (positive/negative) after 1 cycle of BrAVD (central assessment), Response according to Lugano Criteria at end of protocol treatment i.e. after chemotherapy and after radiotherapy (if administered), as defined by FDG-PET/CT, Progression-free survival (where progression, relapse and death from any cause are considered events), Overall survival, Safety and tolerability, Response according to RECIL 2017

Source: https://euclinicaltrials.eu/ctis-public/view/2023-508478-27-00